EU clinical trial 2023-506707-25-00: A Phase III, Multicenter, Randomized, Double-Masked, Active Comparator-Controlled Study to Evaluate the Efficacy and Safety of Faricimab in Patients with Choroidal Neovascularization Secondary to Pathologic Myopia
Protocol code: CR44829
Sponsor: F. Hoffmann-La Roche AG (Pharmaceutical company). Phase: Therapeutic confirmatory (Phase III). Countries: Poland (ended), France (ended), Germany (ended), Spain (ended), Italy (ended).
Therapeutic area(s): Diseases [C] - Eye Diseases [C11]
Gender: Female, Male. Age: 18-64 years, 65+ years. Enrolment: 90.
Status: Ended. Start date (EU): 2024-04-09. End date (EU): 2026-04-02. End date: 2026-05-22. Decision date: 2024-03-26. Results received: No. Last updated: 2026-03-31.
Decision dates by country: DE: 2024-04-02, PL: 2024-04-02, IT: 2024-03-27, FR: 2024-03-26, ES: 2024-03-27

Condition(s): Choroidal neovascularization secondary to pathologic myopia
Product: Lucentis 10 mg/ml solution for injection, FARICIMAB

Primary endpoint: 1. Change from baseline in BCVA averaged over Weeks 4, 8, and 12
Endpoint(s): 1. Change from baseline in BCVA over time, 2. Proportion of patients gaining ≥15 letters averaged over Weeks 4, 8, and 12, 3. Proportion of patients gaining ≥15 letters in BCVA from baseline over time, 4. Proportion of patients avoiding loss of ≥15 letters in BCVA from baseline over time, 5. Proportion of patients gaining ≥15 letters or achieving BCVA of ≥84 letters over time, 6. Proportion of patients with BCVA Snellen equivalent of 20/40 or better over time, 7. Proportion of patients with BCVA Snellen equivalent of 20/200 or worse over time, 8. Proportion of patients only receiving one injection from baseline to Week 12, 9. Proportion of patients only receiving one injection from baseline to Week 24, 10. Proportion of patients only receiving one injection from baseline to Week 48, 11. Number of IVT injections received by Week 12, 12. Number of IVT injections received by Week 24, 13. Number of IVT injections received by Week 48, 14. Change from baseline in central subfield thickness (CST) of the study eye averaged over Weeks 4, 8, and 12, 15. Change from baseline in CST of the study eye over time, 16. Change from baseline in total area of CNV lesion at Week 12 and Week 48, 17. Change from baseline in total area of CNV leakage at Week 12 and Week 48, 18. Proportion of patients with absence of macular leakage at Week 12 and Week 48, 19. Incidence and severity of ocular adverse events, 20. Incidence and severity of non-ocular adverse events, 21. Prevalence of ADAs at baseline and incidence of ADA during the study, 22. Relationship between ADA status and efficacy or safety endpoints

Source: https://euclinicaltrials.eu/ctis-public/view/2023-506707-25-00